EU clinical trial 2024-511983-97-00: International multicentric phase II trial to evaluate the efficacy and safety of pirtobrutinib in combination with rituximab in patients with indolent clinical forms of Mantle Cell Lymphoma
Protocol code: IMCL-2023
Sponsor: Fundacion Geltamo (Patient organisation/association). Phase: Therapeutic exploratory (Phase II). Countries: Portugal (ongoing, recruiting), Spain (ongoing, recruiting).
Therapeutic area(s): Diseases [C] - Hemic and Lymphatic Diseases [C15]
Gender: Female, Male. Age: 18-64 years, 65+ years. Enrolment: 50.
Status: Ongoing, recruiting. Start date (EU): 2025-09-29. Decision date: 2025-06-24. Results received: No. Last updated: 2026-02-10.
Decision dates by country: PT: 2025-06-24, ES: 2025-06-24

Condition(s): Adult patients with indolent MCL who have not previously received treatment (naïve patients).
Product: Jaypirca 100 mg film-coated tablets, MabThera 500 mg concentrate for solution for infusion, MabThera 100 mg concentrate for solution for infusion

Primary endpoint: Primary objective point will be assessed by the complete remission rate (CRR), defined as the percentage of patients who achieve a complete response (CR) at the end of Cycle 6 of the P-R combination according to the Lugano Classification (Appendix 3)
Endpoint(s): The activity of P-R combination will be assessed in the overall population according to the Lugano Classification, The sensitivity, specificity, false positive and negative rates of MRD assays: Allele-specific oligonucleotide real-time quantitative Polymerase chain reaction (ASO-qPCR) and New Generation Sequencing (NGS) based assays., The safety of P-R combination will be assessed by terms of Adverse Events (AEs), Severe Adverse Events (SAEs), Suspected Unexpected Adverse Reactions (SUSARs) during the P-R treatment. All AEs will be classified according to the Common Terminology Criteria for Adverse Events (CTCAE) version 5.0., The changes in the total score between baseline and 6, 12, and 24 months and End of Study (EoS) respectively in patient HRQoL measured by patient reported outcomes (PROs): • The European Organisation for Research and Treatment of Cancer Quality of Life Questionnaire Core 30 items (EORTC-QLQ-C30), and • The Functional Assessment of Cancer Therapy-Lymphoma (FACT)-Lym questionnaire., Longitudinal characterization of tumor samples prior to onset of P-R and at relapse or progression (peripheral blood, plasma, bone marrow and lymph node or other tissues involved) in addition to the study of sequential semestral peripheral blood and plasma samples. The biological characterization will include bulk and single-cell level multi-omics techniques.

Source: https://euclinicaltrials.eu/ctis-public/view/2024-511983-97-00